EU clinical trial 2024-513750-30-00: Pharmacokinetics, Efficacy and Safety of Twice Daily Dosing Regimen of Hydroxycarbamide Dispersible Tablets in Children with Sickle Cell Disease: a single-group, non-randomised, open-label study (KID-BID)
Protocol code: SIK-FR-24-1
Sponsor: Theravia (Pharmaceutical company). Phase: Therapeutic exploratory (Phase II). Countries: France (ongoing, recruiting).
Therapeutic area(s): Diseases [C] - Congenital, Hereditary, and Neonatal Diseases and Abnormalities [C16]; Diseases [C] - Hemic and Lymphatic Diseases [C15]
Gender: Female, Male. Age: 0-17 years. Enrolment: 50.
Status: Ongoing, recruiting. Start date (EU): 2026-03-25. Decision date: 2024-08-20. Results received: No. Last updated: 2026-07-24.

Condition(s): Sickle Cell Disease
Product: SIKLOS PAEDIATRIC 50mg dispersible tablets

Primary endpoint: The primary endpoint is to evaluate the PK exposure for Siklos® Paediatric dispersible tablets administered BID through area under the curve (AUC), time to obtain the maximum concentration (Tmax) and maximum plasma concentration (Cmax) at 1, 3, 6, 9 and 12 months after treatment initiation
Endpoint(s): The absolute mean change from baseline in HbF levels at 3, 6, 9 and 12 months after treatment initiation, HC plasma concentrations and HbF levels recorded throughout study follow-up, Daily AUC (AUC0-24h) at maintenance dose derived from the final PPK model, Relative difference in Cmax ≥30% from BID maintenance dose relative to the one simulated on a once-daily regimen giving an equivalent AUC0-24h, The absolute mean change from baseline in haematological parameters (white blood cell, absolute neutrophil count, lymphocytes, monocytes, eosinophils, basophils, platelets, mean corpuscular volume, mean corpuscular haemoglobin concentration, mean corpuscular haemoglobin, haemoglobin, reticulocytes, red blood cell count) at 1, 3, 6, 9 and 12 months after treatment initiation, Acceptability score based on a hedonic face scale evaluated by the child from 3 years old, 3 months after treatment initiation, Acceptability score based on a 5-point Likert scale evaluated by the parent(s) or legally acceptable representative(s), 3 months after treatment initiation, Distribution of the scores related to the ease of using the administration kit for treatment administration to the child based on a 5-point Likert scale evaluated by the parent(s) or legally acceptable representative(s), 3 months after treatment initiation, Compliance with Siklos® Paediatric dispersible tablets administered BID by treatment unit accountability from treatment initiation to month 12, Number of SCD events occurring during the study, Number of adverse events (AEs) and percentage of patients reporting at least one AE

Source: https://euclinicaltrials.eu/ctis-public/view/2024-513750-30-00